EU clinical trial 2022-502040-13-00: Magrolimab plus intensive chemotherapy in newly diagnosed “ELN intermediate or poor-risk” AML patients intended to undergo allogeneic stem cell transplantation, a Phase 2, Single-arm, Open-Label Study (MAGROLIC)
Protocol code: MAGROLIC
Sponsor: University of Leipzig (Educational Institution). Phase: Therapeutic exploratory (Phase II). Countries: Germany (ended).
Therapeutic area(s): Diseases [C] - Hemic and Lymphatic Diseases [C15]
Gender: Female, Male. Age: 18-64 years, 65+ years. Enrolment: 108.
Status: Ended. End date (EU): 2024-02-08. Decision date: 2023-07-18. Results received: Yes. Last updated: 2023-07-18.

Condition(s): High-risk Myelodysplastic neoplasia, Acute myeloid leukemia
Product: Magrolimab, Cytarabin Accord 100 mg/ml Injektions-/Infusionslösung, Vyxeos Liposomal 44 mg/100 mg powder for concentrate for solution for infusion., Daunoblastin® 20 mg Pulver zur Herstellung einer Infusions- oder Injektionslösung

Primary endpoint: The primary endpoint is CR/CRi/CRh at the end of induction therapy of a maximum of two induction cycles.
Endpoint(s): Overall Survival, OS, i.e. time from study inclusion until death from any cause, Event Free Survival, EFS, i.e. time from study inclusion until non-achievement of a complete remission at the end of induction (after up to two induction chemotherapies), hematological relapse or death from any cause (whichever comes first), Relapse Free Survival, RFS, i.e. the time from achievement of complete remission until hematological relapse, or death from any cause (whichever comes first), only for patients achieving CR, Rate of allogeneic hematopoietic stem cell transplantation, Quality of life, QoL Impact of treatment assessed by using the validated questionnaires EORTC QLQ-C30 and EQ-5D-5L, All AEs and SAEs during induction cycle 1, and possibly induction cycle 2, and consolidation cycles will be collected, CTC-graded, and MEDRA coded. Incidence proportions will be calculated.

Source: https://euclinicaltrials.eu/ctis-public/view/2022-502040-13-00